EU clinical trial 2023-506416-41-00: Comparative Bioavailability of Empagliflozin 25 mg Film-Coated Tablets: A Single-Dose, Open-Label, Randomized, Two-Sequence, Two-Treatment, Two-Period Crossover Study in Healthy Subjects Under Fasting Conditions.
Protocol code: BLCL-EMP-PIL01
Sponsor: Tecnimede-Sociedade Tecnico-Medicinal S.A. (Pharmaceutical company). Phase: Human Pharmacology (Phase I)- Bioequivalence Study. Countries: Portugal (ended).
Therapeutic area(s): Not possible to specify
Gender: Female, Male. Age: 18-64 years. Enrolment: 16.
Status: Ended. Start date (EU): 2023-09-11. End date (EU): 2023-09-30. Decision date: 2023-08-21. Results received: Yes. Last updated: 2023-08-21.

Condition(s): No medical condition
Product: Empagliflozin 25 mg film-coated tablets, Jardiance 25 mg film-coated tablets

Primary endpoint: Cmax and AUC0-t of Empagliflozin.
Endpoint(s): tmax, t1/2, AUC0-∞, %AUCextrap, λz of Empagliflozin., Occurrence of treatment-emergent adverse events (TEAEs), including clinically relevant abnormalities from clinical laboratory tests and vital signs.

Source: https://euclinicaltrials.eu/ctis-public/view/2023-506416-41-00